EU clinical trial 2022-502434-10-00: EORTC 1820-CLTF: Open-Label, phase II, Multi-Center, study of Anti-CCR4 Monoclonal Antibody (mogamulizumab) Plus Total Skin Electron Beam therapy (TSEB) in patients with stage IB-IIB Cutaneous T-Cell Lymphoma (MOGAT)
Protocol code: EORTC-1820-CLTF
Sponsor: European Organisation For Research And Treatment Of Cancer (Patient organisation/association). Phase: Therapeutic exploratory (Phase II). Countries: Spain (ongoing, recruitment ended), Denmark (ongoing, recruitment ended), Italy (ongoing, recruitment ended), France (ongoing, recruitment ended), Germany (ongoing, recruitment ended), Greece (ongoing, recruitment ended).
Therapeutic area(s): Diseases [C] - Neoplasms [C04]
Gender: Female, Male. Age: 18-64 years, 65+ years. Enrolment: 37.
Status: Ongoing, recruitment ended. Start date (EU): 2022-02-22. Decision date: 2024-04-30. Results received: No. Last updated: 2026-04-29.
Decision dates by country: FR: 2024-05-06, DK: 2024-04-30, GR: 2024-07-22, IT: 2024-05-03, ES: 2024-05-07, DE: 2024-05-01

Condition(s): Cutaneous T-cell lymphoma, a category of cancers of lymphocytes (a type of white blood cells) that primarily involve the skin, Cutaneous T-cell lymphoma (Mycosis Fungoides (MF)) and Sézary Syndrome (SS))
Product: MOGAMULIZUMAB

Primary endpoint: Progression Free Survival Rate, at 48 weeks after start of mogamulizumab (PFSR-48).
Endpoint(s): Overall safety of both mogamulizumab and TSEB., Response rate (RR) to both mogamulizumab and TSEB. Time Frame: From the first patient treatment start till 48 weeks as of last patient in Proportion of patients achieving partial response or complete response according to EORTC-ISCL-USCLC criteria, Progression-free survival (PFS). , Overall survival (OS)., Time to progression. , Duration of response., Time to next treatment. , Exploratory endpoints: Quality of life: Skindex-29 and EORTC-QLQ-C30, and time to treatment failure.

Source: https://euclinicaltrials.eu/ctis-public/view/2022-502434-10-00